EU clinical trial 2025-521163-12-01: The use of [68Ga]Ga-FAPI PET/MRI in assessing disease activity in patients with Graves’ orbitopathy
Sponsor: Erasmus Universitair Medisch Centrum Rotterdam (Erasmus MC) (Hospital/Clinic/Other health care facility). Phase: Phase I and Phase II (Integrated)- Other. Countries: Netherlands (authorised, recruitment pending).
Therapeutic area(s): Diseases [C] - Immune System Diseases [C20]; Diseases [C] - Eye Diseases [C11]; Analytical, Diagnostic and Therapeutic Techniques and Equipment [E] - Diagnosis [E01]
Gender: Female, Male. Age: 18-64 years, 65+ years. Enrolment: 10.
Status: Authorised, recruitment pending. Decision date: 2025-10-30. Results received: No. Last updated: 2025-10-30.

Condition(s): Graves' Orbitopathy
Product: 68GA-FAPI-46

Primary endpoint: FAPI uptake in active GO versus inactive GO on PET-MRI
Endpoint(s): Relation MRI results (edema), clinical symptoms, and lab values to FAPI-uptake on PET.

Source: https://euclinicaltrials.eu/ctis-public/view/2025-521163-12-01